EU clinical trial 2023-508817-18-00: A Phase 3, Multicenter, Randomized, Double-Blind, Placebo-controlled, Parallel Group Study to Evaluate the Efficacy and Safety of Lebrikizumab/ LY3650150 in Adult Participants With Perennial Allergic Rhinitis
Protocol code: J2T-MC-KGBT
Sponsor: Eli Lilly & Co. (Pharmaceutical company). Phase: Therapeutic confirmatory (Phase III). Countries: Poland (ongoing, recruitment ended), Germany (ongoing, recruitment ended), Belgium (ongoing, recruitment ended).
Therapeutic area(s): Diseases [C] - Otorhinolaryngologic Diseases [C09]; Diseases [C] - Respiratory Tract Diseases [C08]
Gender: Female, Male. Age: 18-64 years, 65+ years. Enrolment: 258.
Status: Ongoing, recruitment ended. Start date (EU): 2024-10-08. Decision date: 2024-08-05. Results received: No. Last updated: 2025-10-20.
Decision dates by country: PL: 2024-08-06, DE: 2024-08-06, BE: 2024-08-05

Condition(s): Perennial Allergic Rhinitis (PAR)
Product: Lebrikizumab, Placebo for Lebrikizumab, MOMETASONE

Primary endpoint: 1. Mean Change From Baseline (CFBL) in Total Nasal Symptom Score (TNSS) at Week 16 Total nasal symptom score was a composite of 4 symptoms (rhinorrhea, nasal congestion, nasal itching and sneezing), each symptom was scored on a scale of 0 = none, 1 = mild, 2 = moderate, 3 = severe. The total score ranged from 0 to 12. The higher the score was, the more severe the symptoms were. [Time Frame: Baseline, Week 16]

Source: https://euclinicaltrials.eu/ctis-public/view/2023-508817-18-00